EU clinical trial 2024-514695-41-00: A Phase 3, Multi-Center Study to Evaluate the Pharmacokinetics, Efficacy, and Safety of Risankizumab with Open-Label Induction, Randomized Double-Blind Maintenance, and Open-Label Long-Term Extension Periods in Pediatric Subjects (2 to < 18 Years of Age) with Moderately to Severely Active Ulcerative Colitis
Protocol code: M19-751
Sponsor: AbbVie Deutschland GmbH & Co. KG (Pharmaceutical company). Phase: Therapeutic confirmatory (Phase III). Countries: Sweden (ongoing, recruiting), Greece (ongoing, recruiting), Germany (ongoing, recruiting), Italy (ongoing, recruiting), Belgium (authorised, recruiting), Spain (authorised, recruiting).
Therapeutic area(s): Diseases [C] - Digestive System Diseases [C06]
Gender: Female, Male. Age: 0-17 years. Enrolment: 34.
Start date (EU): 2025-10-17. Decision date: 2025-08-29. Results received: No. Last updated: 2026-06-30.
Decision dates by country: IT: 2025-09-02, BE: 2025-08-29, DE: 2025-09-02, ES: 2025-09-03, GR: 2025-09-02, SE: 2025-09-01

Condition(s): Ulcerative Colitis
Product: risankizumab placebo, ABBV-066 / Risankizumab, Risankizumab, ABBV-066

Primary endpoint: PK Lead-in Cohort 1 and Cohort 2: Maximum Observed Serum Concentration (Cmax), PK Lead-in Cohort 1 and Cohort 2: Time to Maximum Serum Concentration (Tmax), PK Lead-in Cohort 1 and Cohort 2: Area Under the Serum Concentration-Time Curve Over the Dosing Interval (AUCtau), Expansion Cohort 3: Achievement of Clinical Remission per Modified Mayo Score (mMS) at Week 64 Among Week 12 Clinical Responders per mMS
Endpoint(s): PK Lead-In Cohort 1 and Cohort 2: Achievement of clinical remission per mMS at Week 64 among Week 12 responders per mMS, PK Lead-In Cohort 1 and Cohort 2: Achievement of clinical remission per mMS at Week 12, PK Lead-In Cohort 1 and Cohort 2: Achievement of clinical response per mMS at Week 12, PK Lead-In Cohort 1 and Cohort 2: Achievement of endoscopic improvement at Week 12, PK Lead-In Cohort 1 and Cohort 2: Symptomatic response per partial mMS at Week 12, PK Lead-In Cohort 1 and Cohort 2: Achievement of clinical response per mMS at Week 64 among Week 12 responders per mMS, PK Lead-In Cohort 1 and Cohort 2: Achievement of endoscopic improvement at Week 64 among Week 12 responders per mMS, PK Lead-In Cohort 1 and Cohort 2: Achievement of corticosteroid-free (at least 90 days without corticosteroid exposure) clinical remission per mMS at week 64 among Week 12 responders per mMS, Expansion Cohort 3: Achievement of clinical remission per mMS at Week 12, Expansion Cohort 3: Achievement of clinical response per mMS at Week 12, Expansion Cohort 3: Achievement of endoscopic improvement at Week 12, Expansion Cohort 3: Symptomatic response per partial mMS at Week 12, Expansion Cohort 3: Achievement of clinical response per mMS at Week 64 among Week 12 responders per mMS, Expansion Cohort 3: Achievement of endoscopic improvement at Week 64 among Week 12 responders per mMS, Expansion Cohort 3: Achievement of corticosteroid-free clinical remission per mMS at Week 64 among Week 12 responders per mMS

Source: https://euclinicaltrials.eu/ctis-public/view/2024-514695-41-00